EU clinical trial 2024-514771-18-00: A Phase III, Randomized, Double-blind Study to Assess the Efficacy and Safety of Lazertinib versus Gefitinib as the First-line Treatment in Patients with Epidermal Growth Factor Receptor Sensitizing Mutation Positive, Locally Advanced or Metastatic Non-Small Cell Lung Cancer
Protocol code: YH25448-301
Sponsor: Yuhan Corp. (Pharmaceutical company). Phase: Therapeutic confirmatory (Phase III). Countries: Hungary (ended), Greece (ended).
Therapeutic area(s): Diseases [C] - Neoplasms [C04]
Gender: Female, Male. Age: 18-64 years, 65+ years. Enrolment: 5.
Status: Ended. Start date (EU): 2020-12-15. End date (EU): 2026-04-21. End date: 2026-04-22. Decision date: 2024-08-21. Results received: Yes. Last updated: 2026-02-26.
Decision dates by country: GR: 2024-11-13, HU: 2024-08-21

Condition(s): Adenocarcinoma of the lung (non-small cell lung cancer); locally advanced or metastatic, not amenable to curative surgery or radiotherapy
Product: Lazertinib, Gefitinib-ratiopharm 250 mg Filmtabletten

Primary endpoint: Progression-free survival according to RECIST v1.1 by Investigator assessment
Endpoint(s): • Objective Response Rate (ORR) • Duration of Response (DoR) • Disease Control Rate (DCR) • Depth of Response • Time to Response All according to RECIST v1.1 by Investigator assessments, Overall survival (OS), • Plasma concentrations of lazertinib • Cerebrospinal fluid (CSF) concentrations of lazertinib, Change from baseline in : • European Organization for Research and Treatment of Cancer Quality of Life Questionnaire – Core 30 items (EORTC QLQ-C30) • European Organization for Research and Treatment of Cancer Quality of Life Questionnaire – Lung Cancer 13 items (EORTC QLQ-LC13) • Euro-Quality of Life-5 Dimension-5 level (EQ-5D-5L)

Source: https://euclinicaltrials.eu/ctis-public/view/2024-514771-18-00